EU clinical trial 2024-515080-54-00: Pre-operative phase II trial for breast cancer with nivolumab in combination with novel IO (BELLINI trial)
Protocol code: M18BEL
Sponsor: Het Nederlands Kanker Instituut-Antoni van Leeuwenhoek Ziekenhuis Stichting (Hospital/Clinic/Other health care facility). Phase: Therapeutic exploratory (Phase II). Countries: Netherlands (ongoing, recruiting).
Therapeutic area(s): Diseases [C] - Neoplasms [C04]
Gender: Female. Age: 18-64 years, 65+ years. Enrolment: 120.
Status: Ongoing, recruiting. Start date (EU): 2019-08-15. Decision date: 2024-12-02. Results received: No. Last updated: 2026-06-29.

Condition(s): Breast cancer
Product: Paclitaxel Fresenius Kabi, CYCLOPHOSPHAMIDE, Relatlimab intravenous, Doxorubicine HCl Hikma 2 mg/ml, concentraat voor oplossing voor infusie, IPILIMUMAB, OPDIVO 10 mg/mL concentrate for solution for infusion.

Primary endpoint: pathological complete response rate per cohort, with a pCR defined as no residual invasively growing tumor cells detected by microscopic examination in breast and axilla.
Endpoint(s): incidence, nature and severity of Adverse Events graded according to NCI-CTCAE v5.0 collected during treatment and up to 3 weeks post-surgery., Radiological response using breast MRI per cohort, Event-free survival (EFS), Overall survival (OS), Immune activation after pre-operative nivolumab, either as monotherapy or in combination with ipilimumab or relatlimab or novel IO combinations

Source: https://euclinicaltrials.eu/ctis-public/view/2024-515080-54-00